EU clinical trial 2024-518405-18-00: Cerebral neuroinflammation during major depressive episode: multicentric comparative study (InflaDep)
Protocol code: RC31/16/8918
Sponsor: Centre Hospitalier Universitaire De Toulouse (Hospital/Clinic/Other health care facility). Phase: Therapeutic use (Phase IV). Countries: France (ended).
Therapeutic area(s): Psychiatry and Psychology [F] - Mental Disorders [F03]; Psychiatry and Psychology [F] - Psychological Phenomena [F02]
Gender: Female, Male. Age: 18-64 years. Enrolment: 60.
Status: Ended. Start date (EU): 2018-12-07. End date (EU): 2025-12-18. Decision date: 2024-12-03. Results received: No. Last updated: 2025-02-24.

Condition(s): Depressive disorder
Product: 18F-DPA-714

Primary endpoint: TSPO density assessed by the cerebral distribution volume of the tracer [18F]DPA-714 in the experimental group versus the control group.
Endpoint(s): the density of the TSPO evaluated by the cerebral distribution volume of the tracer [18F]DPA-714 in the 3 groups (experimental, control and pathological control)., psychometric scales making it possible to assess the clinical state of subjects: o Depression scale (MADRS) o Anhedonia Scale (SHAPS) o Psychomotor slowing scale (Widlocher scale) o Suicide Risk Rating Scale (CSSRS) o BAS Anxiety Rating Scale (Brief Scale for Anxiety), imagery markers o by structural MRI (i.e. the cortical thickness allowing the quantification of cortical atrophy) o diffusion (i.e. the average diffusivity allowing microstructural integrity to be measured) o T2* relaxometry (i.e. R2* to measure intracerebral iron content) o Resting functional MRI (i.e. connectivity strength of the default mode network), concentrations of biological markers of peripheral inflammation (TNF alpha and IL6), Proteomics: identification of plasma proteins and relative quantification of their abundances

Source: https://euclinicaltrials.eu/ctis-public/view/2024-518405-18-00